EU clinical trial 2025-524842-89-00: HOVON 180 CLL: Prospective phase II trial of pirtobrutinib treatment (24 cycles) with 12 cycles of epcoritamab in patients with relapsed or refractory chronic lymphocytic leukemia or small lymphocytic lymphoma. ODYSSEUS study (Outcome-Driven trial for relapsed CLL/SLL combining BTK and bispecific antibodY to improve outcome)
Sponsor: Hemato-Oncologie voor Volwassenen Nederland (Hovon) Stichting (Patient organisation/association). Phase: Therapeutic exploratory (Phase II). Countries: Netherlands (authorised, recruitment pending).
Therapeutic area(s): Diseases [C] - Hemic and Lymphatic Diseases [C15]; Diseases [C] - Neoplasms [C04]
Gender: Female, Male. Age: 18-64 years, 65+ years. Enrolment: 58.
Status: Authorised, recruitment pending. Decision date: 2026-07-20. Results received: No. Last updated: 2026-07-20.

Condition(s): chronic lymphocytic leukemia (CLL) and small lymphocytic lymphoma (SLL)
Product: Jaypirca 100 mg film-coated tablets, Epcoritamab (GEN3013), Epcoritamab (GEN3013)

Primary endpoint: Safety Run-In: Safety based on AESI and the key SLT definitions following the addition of epcoritamab to pirtobrutinib after three cycles of pirtobrutinib monotherapy, Cohort expansion: PFS at 24 months, PFS defined as time from first dose of pirtobrutinib to the first occurrence of disease progression or death due to any cause, whichever occurs first.
Endpoint(s): uMRD4 in BM in absence of progression according to IWCLL criteria, at 12 weeks after the last epcoritamab cycle., uMRD4 in PB in absence of progression according to the IWCLL criteria, at 12 weeks after the last treatment day, i.e., day 28, of cycle 24, Depth (level) of MRD measured in PB after cycle 4, 9, 15, 18, 24, 12 weeks after day 28 of cycle 24 and 12 and 24 months after cycle 24, OS, defined as the time from from first dose of pirtobrutinib to death due to any cause, ORR, defined as the proportion of participants with a CR, CRi, or PR according to IWCLL 2018 criteria, EFS, defined as time from from first dose of pirtobrutinib to date of premature cessation of both study drugs due to toxicity, initiation another therapy directed against CLL, progression or death, whichever comes first, TOT, defined as time from date first drug administration to date last drug administration for pritobrutinib and epcoritamab separately, TTNT, defined as time from registration to initiation of another therapy directed against CLL, TFS, defined as time from date of last pirtobrutinib or epcoritamab treatment to date of initiation of another therapy directed against CLL, or death from any cause, whichever comes first, DOR, defined as time from first response (i.e., ≥PR and CR(i)) to PD or death from any cause, Type, frequency, length and severity of AEs and AESI and their relationship to study treatment (determined according to NCI CTCAE V 6.0), and grading of hematologcial toxicity according to IWCLL2018, Health-related QoL as assessed by EORTC QLQ-C30, QLQ-CLL17 and PRO-CTCAE questionnaires, Exploratory endpoint: Association between uMRD4 (after cycle 4, 9, 15, 18 (PB and BM), 24) with MRD 12 weeks after cycle 24 and PFS/OS 12/24 months after cycle 24, Exploratory endpoint: Association between MRD by flow (cycle 4, 9, 15, 18 (PB and BM), 24 and 12 weeks after 24) and MRD by NGS at end of cycle 18 on BM, Exploratory endpoint: Disease status and responses by CT responses at baseline, after cycle 9, cycle 18, 12 weeks after cycle 24 or corresponding time-point in participants who stopped earlier for other reason than PD, Exploratory endpoint: Immunophenotyping and functional T-cell studies and TCR clonality profiling, Exploratory endpoint: Immune markers in relation to CRS and infections, Exploratory endpoint: Correlation between outcomes (ORR, MRD, PFS) and baseline molecular and biological factors (IGHV mutation status, TP53 mutations, genomic complexity, tumor burden) or early MRD (cycle 4)

Source: https://euclinicaltrials.eu/ctis-public/view/2025-524842-89-00